EU clinical trial 2026-526149-91-00: Efficacy and safety of Dalbavancin in the treatment of infective Endocarditis caused by gram-positive cocci
Protocol code: ZKSJ0165
Sponsor: Friedrich-Schiller-Universitaet Jena (Educational Institution). Phase: Therapeutic confirmatory (Phase III). Countries: Germany (authorised, recruitment pending).
Therapeutic area(s): Diseases [C] - Cardiovascular Diseases [C14]; Diseases [C] - Bacterial Infections and Mycoses [C01]
Gender: Female, Male. Age: 18-64 years, 65+ years. Enrolment: 166.
Status: Authorised, recruitment pending. Decision date: 2026-06-30. Results received: No. Last updated: 2026-06-30.

Condition(s): Infectious endocarditis caused by Gram-positive cocci (staphylococci, enterococci, streptococci)
Product: LEVOFLOXACIN, BENZYLPENICILLIN POTASSIUM, DOXYCYCLINE, DAPTOMYCIN, CIPROFLOXACIN, CEFOTAXIME, AMOXICILLIN, CEFTRIAXONE, MOXIFLOXACIN, CEFALEXIN, FOSFOMYCIN, AMPICILLIN, DALBAVANCIN, RIFAMPICIN, CIPROFLOXACIN, AMOXICILLIN, FLUCLOXACILLIN, CEFACLOR, MOXIFLOXACIN, AMPICILLIN, SULFAMETHOXAZOLE, CEFAZOLIN, CEFTAROLINE FOSAMIL, TRIMETHOPRIM, IMIPENEM, SULBACTAM, TRIMETHOPRIM, SULFAMETHOXAZOLE, LINEZOLID, RIFAMPICIN, VANCOMYCIN, PHENOXYMETHYLPENICILLIN, DOXYCYCLINE, GENTAMICIN SULFATE, CILASTATIN, LINEZOLID, MEROPENEM, CLAVULANIC ACID, TEICOPLANIN, LEVOFLOXACIN

Primary endpoint: Comparison of the Desirability of Outcome Ranking (DOOR) on Day 90 between patients treated with dalbavancin and those treated with standard therapy. Five possible DOOR ratings are distinguished: • Alive, no events • Alive, one event • Alive, two events • Alive, three events • Death within 90 days. Door events include: Cardiac surgery, Infectious complication, Embolic event
Endpoint(s): Health economic parameters at T90 (including length of hospital stay in days; costs of antibiotic therapy; number of days of work disability), Neurological outcome (National Institutes of Health Stroke Scale (NIHSS), modified Rankin Scale (mRS) at Day 90 and 1 year, Health-related quality of life (PROMIS-29 domain-specific T-scores and pain intensity, EQ-5D-5L index and VAS, RNLI total score) at 90 days and 1 year, Overall mortality at 90 days and 1 year, Cardiac surgery at 90 days and 1 year, Infectious complications at 90 days and 1 year, Embolic event at 90 days and 1 year, Clinical Frailty Scale at 90 days and 1 year, Occurrence of treatment-related adverse events (T0 to EOT+14 days), Dalbavancin level determination and pharmacokinetic analysis (only patients in the intervention group) T1, T2, T14, and if applicable, T21/28/35, Microbiome analysis and resistance development (nasopharyngeal and rectal swabs/stool samples) T0, T90, and 1 year

Source: https://euclinicaltrials.eu/ctis-public/view/2026-526149-91-00